EU clinical trial 2025-520731-17-02: 68Ga-FAPI PET/CT imaging to assess pulmonary artery and right ventricle remodeling SoFAPI study
Protocol code: 29BRC24.0296
Sponsor: Centre Hospitalier Regional Et Universitaire De Brest (Hospital/Clinic/Other health care facility). Phase: Therapeutic confirmatory (Phase III). Countries: France (authorised, recruitment pending).
Therapeutic area(s): Diseases [C] - Respiratory Tract Diseases [C08]; Analytical, Diagnostic and Therapeutic Techniques and Equipment [E] - Diagnosis [E01]
Gender: Female, Male. Age: 18-64 years, 65+ years. Enrolment: 15.
Status: Authorised, recruitment pending. Decision date: 2025-10-24. Results received: No. Last updated: 2026-05-04.

Condition(s): Pulmonary arterial hypertension (PAH)
Product: 68-FAPI-46, Winrevair 60 mg powder and solvent for solution for injection, [68Ga]Ga-MAA, Winrevair 45 mg powder and solvent for solution for injection

Primary endpoint: [68Ga] Ga-FAPI uptake (Yes/No) of pulmonary arteries on PET/CT imaging in patients with PAH at V0. The uptake will be assessed visually and outcome considered as success by consensus of two nuclear medicine physicians, using the surrounding vascular background as a reference.
Endpoint(s): [68Ga] Ga-FAPI uptake on pulmonary arteries at V1 and V2(after 24 weeks treatment with Sotatercept). This will be assessed using a visual scale and the Standardized uptake value (SUVmax)., Regional lung perfusion will be assessed by quantifying the Pulmonary vascular obstruction index (PVOI) on [68Ga]Ga-MAA lung perfusion PET/CT at V1 and V2 (after 24 weeks treatment with Sotatercept), [68Ga] Ga-FAPI uptake on the RV (SUVmax) and a RV ventricule dysfunction based on Tricuspid annular plane systolic excursion (TAPSE)<17mm., [68Ga] Ga-FAPI uptake on the RV (SUVmax) at V1 and V2, [68Ga] Ga-FAPI uptake on pulmonary arteries (SUVmax) will be correlated with hemodynamic parameters on RHC (PAPm, CO, RAP, RVP, PVR), [68Ga] Ga-FAPI uptake on pulmonary arteries (SUVmax) will be correlated with 6 minutes walking test result (6MWT) in PAH patients, [68Ga] Ga-FAPI uptake on pulmonary arteries (SUVmax) will be correlated with NYHA functional class in PAH patients, [68Ga] Ga-FAPI uptake on pulmonary arteries (SUVmax) will be correlated with Nt-proBNP measure in PAH patients, [68Ga] Ga-FAPI uptake on pulmonary arteries (SUVmax) will be correlated with quality of life (Emphasis 10) measure in PAH patients, Qualitative and quantitative evaluation of imaging parameters, including image quality and reproducibility, acquisition time, radiation dose, ease of interpretation, technical success rate, inter-operator variability, and the impact of acquisition parameters on biomarker quantification.

Source: https://euclinicaltrials.eu/ctis-public/view/2025-520731-17-02